EU clinical trial 2023-504373-20-00: A Phase 2b Clinical Study of the P38 Alpha Kinase Inhibitor Neflamapimod in Patients with Dementia with Lewy Bodies (DLB)
Protocol code: EIP21-NFD-504
Sponsor: Eip Pharma Inc. (Pharmaceutical company). Phase: Therapeutic exploratory (Phase II). Countries: Netherlands (ended).
Therapeutic area(s): Diseases [C] - Nervous System Diseases [C10]
Gender: Female, Male. Age: 18-64 years, 65+ years. Enrolment: 15.
Status: Ended. Start date (EU): 2023-08-09. End date (EU): 2025-05-12. End date: 2025-06-16. Decision date: 2023-07-24. Results received: Yes. Last updated: 2025-03-25.

Condition(s): Subjects aged ≥55 years with probable Dementia with Lewy Bodies DLB by consensus criteria (McKeith et al, 2017), including a positive DaTscan™ and a CDR Global Score of 0.5 or 1.0. If the DaTscan is negative, but the subject has historical polysomnography (PSG)-verified REM sleep behavioral disorder (RBD), this will also qualify as probable DLB.
Product: DaTSCAN 74 MBq/ml solution for injection, capsules are reddish-orange opaque hard gelatin capsules with no markings containing a yellow powder. The complete statement of components and composition of Placebo Capsules to match the 40 mg active capsules is: - Lactose Monohydrate; - Croscarmellose Sodium; - Povidone K30 USP Binder; - Magnesium Stearate, Non-Bovine (Hyqual); - Capsules, Empty, Hard Gelatin Size 0, Swedish Orange, Opaque, Unmarked, Neflamapimod

Primary endpoint: Change (from Baseline to Week 16) in CDR-SB in neflamapimod treated-subjects compared to the placebo-treated subjects.
Endpoint(s): Change (from Baseline to Week 16) in TUG in neflamapimod-treated subjects compared to placebo-recipients., Change (from Baseline to Week 16) in the composite score of the NTB, including tests of attention, executive function, and visual learning in neflamapimod-treated subjects compared to placebo-recipients., ADCS-CGIC score at Week 16 in neflamapimod-treated subjects compared to placebo-recipients.

Source: https://euclinicaltrials.eu/ctis-public/view/2023-504373-20-00